EU clinical trial 2023-504572-25-00: INJECTABL-II trial: Dose finding, efficacy and immunological response of a novel immuno-adjuvant (IP-001) following microwave ablation or irreversible electroporation for colorectal liver metastases.
Sponsor: Amsterdam UMC (Hospital/Clinic/Other health care facility). Phase: Phase I and Phase II (Integrated)- Other. Countries: Netherlands (ongoing, recruiting).
Therapeutic area(s): Analytical,Diagnostic,Therapeutic Techniques and Equipment [E]-Surgical Procedures, Operative [E04]; Analytical, Diagnostic and Therapeutic Techniques and Equipment [E] - Therapeutics [E02]
Gender: Female, Male. Age: 18-64 years, 65+ years. Enrolment: 119.
Status: Ongoing, recruiting. Start date (EU): 2024-06-25. Decision date: 2024-05-13. Results received: No. Last updated: 2026-06-19.

Condition(s): Colorectal liver metastases

Source: https://euclinicaltrials.eu/ctis-public/view/2023-504572-25-00